EU clinical trial 2024-512824-13-01: Guided by Light: Optimizing Surgical Excision of Oral Cancer Using Real-time Fluorescence Imaging
Protocol code: NL71347.078.20
Sponsor: Erasmus Universitair Medisch Centrum Rotterdam (Erasmus MC) (Hospital/Clinic/Other health care facility). Phase: Phase I and Phase II (Integrated)- First administration to humans. Countries: Netherlands (authorised, recruitment pending).
Therapeutic area(s): Diseases [C] - Neoplasms [C04]
Gender: Female, Male. Age: 18-64 years, 65+ years. Enrolment: 31.
Status: Authorised, recruitment pending. Decision date: 2024-12-17. Results received: No. Last updated: 2024-12-17.

Condition(s): Oral cancer
Product: cRGD-ZW800-1

Primary endpoint: Rate of adequate (i.e. >5mm clear) tumor resection margins.
Endpoint(s): Sensitivity, specificity, positive and negative predictive values, Co-localization of FLI with immunohistochemistry on pathology slides, Percentage of extra tissue resection based on FLI-driven frozen sections, Operation time, FLI of lymph node metastases after neck dissection

Source: https://euclinicaltrials.eu/ctis-public/view/2024-512824-13-01